EU clinical trial 2025-524212-11-00: A randomized double-blind placebo-controlled study to demonstrate the efficacy of PMBL® sublingual tablets in reducing the incidence of respiratory tract infections in children aged 3-12 years (PIRTIK).
Protocol code: LPI-2501
Sponsor: Lallemand Pharma Europe filial af Lallemand Pharma AG Schweiz (Pharmaceutical company). Phase: Therapeutic use (Phase IV). Countries: Poland (ongoing, recruiting).
Therapeutic area(s): Diseases [C] - Respiratory Tract Diseases [C08]
Gender: Female, Male. Age: 0-17 years. Enrolment: 224.
Status: Ongoing, recruiting. Start date (EU): 2026-05-18. Decision date: 2026-04-23. Results received: No. Last updated: 2026-04-23.

Condition(s): Respiratory Tract Infections
Product: PLACEBO, ISMIGEN tabletki podjezykowe

Primary endpoint: Rate of Respiratory Tract Infections (RTIs): the number of RTIs experienced by a subject throughout the study (3 month-treatment period and 4 month-follow-up) will be assessed.
Endpoint(s): - % of pts free of RTI during the overall study period - Mean duration in days per RTI during the overall study period (OST) – No. of days with RTI during the OST – No. of days of antibiotics use during the OST - Total no. of workdays lost by parents due to their child’s RTI during the OST – No. of physician consultations due to RTI or related complications – No. of antibiotic treatments (courses) for a respiratory event during the OST – No. of pts with (serious) AE and (serious) ADR

Source: https://euclinicaltrials.eu/ctis-public/view/2025-524212-11-00